EU clinical trial 2023-508728-36-00: A randomized, double-blind, vehicle-controlled, multi-centre, parallel-group study to investigate the safety, tolerability, and efficacy of GR1014 cutaneous gel as a topical radioprotector in the prevention of the radiodermatitis occurring with adjuvant radiotherapy for localized breast cancer after lumpectomy
Protocol code: GRA.05.SPR.0001
Sponsor: Graegis Pharmaceuticals Limited (Pharmaceutical company). Phase: Therapeutic exploratory (Phase II). Countries: France (ended).
Therapeutic area(s): Diseases [C] - Skin and Connective Tissue Diseases [C17]
Gender: Female. Age: 18-64 years, 65+ years. Enrolment: 191.
Status: Ended. Start date (EU): 2024-07-26. End date (EU): 2025-12-01. End date: 2025-12-02. Decision date: 2024-05-21. Results received: Yes. Last updated: 2025-05-14.

Condition(s): Radiation-induced dermatitis (radiodermatitis)
Product: GR1014 Cutaneous Gel, The placebo ingredients are identical to those of GR1014-CG with the exception that the drug substance (amifostine) and hydrochloric acid (used at the hydrolysis step to convert amifostine in the active substance, amifostine thiol) are omitted.

Primary endpoint: Percentage of participants with no radiation dermatitis (Common Terminology Criteria for Adverse Events latest version [CTCAE LV] grade of 0) between the first RT session and 4 weeks after the last one.
Endpoint(s): Percentage of participants with a radiodermatitis grade ≥2 (CTCAE LV) occurring at any time between the first RT session and 4 weeks after the last one – key secondary., Percentage of participants with no radiation dermatitis (CTCAE LV, grade of 0), 4 weeks after the last RT session (at Visit 10)., Maximum grade of radiodermatitis (CTCAE LV) reached in each participant between the first RT session and 4 weeks after the last one., Assessments of radiodermatitis grade (CTCAE LV) between the first RT session and the last visit., Time to onset of radiodermatitis grade ≥2 (CTCAE LV)., Duration of radiodermatitis grade ≥2 (CTCAE LV)., Percentage of participants with severe radiodermatitis (grade ≥3; CTCAE LV) occurring at any time between the first RT session and 4 weeks after the last one., Number of cases of side effects of RT other than radiodermatitis occurring at any time between the first RT session and the last visit (oedema; hyperpigmentation; skin infection; need for topical and systemic antibiotics; need for topical steroids; need for analgesics; need for silicone-based dressings)., Absolute change from baseline in weekly averaged worst skin pain score in the irradiated area. Worst pain intensity (during the last 24 hours) will be scored daily on a 0-10 Numeric Rating Scale (NRS),) from first to last visit., Absolute change from baseline in weekly averaged peak pruritus score in the irradiated area. Peak pruritus intensity (during the last 24 hours) will be scored daily on a 0-10 NRS, from first to last visit., Total score and sub-scores of Dermatology Life Quality Index (DLQI) weekly addressed, from the first RT session to the last visit., Breast skin surface inflammation evolution will be assessed through a repeated measures analysis of the skin colour a-star (a*) values calculated using a tristimulus colorimetric instrument in accordance with the CIELAB colour systems from the first RT session to the last visit., Transepidermal water loss (TEWL) measured from the first RT session to the last visit for 4 test areas within the radiation field of the breast (1 site per quadrant) and on a control area of the volar aspect of the forearm on the non-irradiated side., Serious Adverse Reactions (SARs)., Adverse Events of Special Interest (AESIs)., Percentage of study withdrawal., Stop/delay in RT sessions due to safety events., Cmax, Time to Cmax (Tmax), Area under the plasma concentration-time curve from time 0 to the last measurable time point tlast (AUClast)

Source: https://euclinicaltrials.eu/ctis-public/view/2023-508728-36-00